EU clinical trial 2024-514079-17-00: An Open-Label Extension Study of the Safety of Relacorilant (CORT125134) in the Treatment of the Signs and Symptoms of Endogenous Cushing Syndrome
Protocol code: CORT125134-452
Sponsor: Corcept Therapeutics Inc. (Pharmaceutical company). Phase: Phase II and Phase III (Integrated). Countries: Spain (ongoing, recruitment ended), Bulgaria (ended), Germany (ended), Netherlands (ended), Italy (ongoing, recruitment ended), Austria (ended), Romania (ongoing, recruitment ended), Poland (ongoing, recruitment ended).
Therapeutic area(s): Phenomena and Processes [G] - Physiological processes [G07]
Gender: Female, Male. Age: 18-64 years, 65+ years. Enrolment: 76.
Start date (EU): 2020-05-28. Decision date: 2024-09-05. Results received: No. Last updated: 2025-02-13.
Decision dates by country: AT: 2024-10-20, BG: 2024-09-13, DE: 2024-09-26, RO: 2024-10-07, ES: 2024-09-06, NL: 2024-09-05, PL: 2024-10-13, IT: 2024-09-11

Condition(s): Endogenous Cushing Syndrome

Primary endpoint: Incidence of treatment-emergent adverse events (TEAEs) (assessed monthly): TEAEs, serious TEAEs (SAEs), treatment-related TEAEs, TEAEs leading to early discontinuation of study treatment., Changes from Baseline in clinical laboratory tests (hematology and chemistry panels)., Changes from Baseline in physical examinations and vital sign measurements., Changes from Baseline in electrocardiograms (ECGs) (12-lead) (including QTcF interval, QRS complex, PR interval, and heart rate)., Changes from Baseline in pituitary tumors based on magnetic resonance imaging (MRI) scans in patients with Cushing disease.

Source: https://euclinicaltrials.eu/ctis-public/view/2024-514079-17-00